EU clinical trial 2024-518500-47-00: Repurposing statins as adjuvants for cancer patients receiving therapy with immune checkpoint inhibitors: the STARK trial
Protocol code: 2024-518500-47-00
Sponsor: Universita Degli Studi Di Padova (Educational Institution). Phase: Therapeutic exploratory (Phase II). Countries: Italy (ongoing, recruiting).
Therapeutic area(s): Diseases [C] - Neoplasms [C04]
Gender: Female, Male. Age: 18-64 years, 65+ years. Enrolment: 90.
Status: Ongoing, recruiting. Start date (EU): 2026-04-07. Decision date: 2025-07-16. Results received: No. Last updated: 2025-07-16.

Condition(s): Non Small Cell Lung Cancer (NSCLC), Triple Negative Breast Cancer (TNBC)
Product: TORVAST 40 mg compresse rivestite con film

Primary endpoint: In Cohort 1, the immunomodulatory role of Atorvastatin will be assessed by comparing the relative change in the density (cells/mm2) of CD8+/PD-1+ cells from T0 to T1 (Cohort 1) between treatment arms, as assessed by multiplex immunofluorescence (mIF) on tumor samples., In Cohort 2, the proportion of patients with a decrease of at least 50% in the percent change of maximum VAF (maxVAF) in ctDNA in the first 6 weeks of treatment (maximum VAFT1−maximum VAFT0/maximum VAFT0) will be compared between treatment arms as a surrogate measure of treatment efficacy.
Endpoint(s): Efficacy endpoints focused on assessing the impact of adding Atorvastatin to ICI therapy on response rates and survival metrics, such as pathological complete-response rate (pCR) for Cohort 1 and Overall Response Rate (ORR), progression-free survival (PFS) and overall survival (OS) for Cohort 2., Safety objectives will evaluate the risks associated with Atorvastatin and ICI-based therapy, including the incidence and severity of adverse events, graded according to NCI CTCAE v5.0., Translational objectives aimed to identify prognostic and predictive immune-metabolic markers influenced by Atorvastatin and ICI therapies, using technologies such as spatial profiling, RNA-sequencing (RNAseq), plasma metabolomics by Ultra Performance Liquid Chromatography (UPLC)/Mass Spectrometry (MS) and peripheral blood mononuclear cells (PBMCs).

Source: https://euclinicaltrials.eu/ctis-public/view/2024-518500-47-00